EU clinical trial 2023-504978-38-00: A Phase 3 Study of the Efficacy, Safety, and Pharmacokinetics of Ustekinumab as Open-label Intravenous Induction Treatment Followed by Randomized Double-blind Subcutaneous Ustekinumab Maintenance in Pediatric Participants with Moderately to Severely Active Crohn’s Disease
Protocol code: CNTO1275CRD3004
Sponsor: Janssen - Cilag International (Pharmaceutical company). Phase: Therapeutic confirmatory (Phase III). Countries: Hungary (ended), Germany (ended), Belgium (ended), Poland (ended).
Therapeutic area(s): Diseases [C] - Immune System Diseases [C20]
Gender: Female, Male. Age: 0-17 years. Enrolment: 60.
Status: Ended. Start date (EU): 2021-03-16. End date (EU): 2025-03-03. End date: 2025-03-04. Decision date: 2023-08-15. Results received: Yes. Last updated: 2024-09-24.
Decision dates by country: BE: 2023-09-18, DE: 2023-08-29, PL: 2023-10-16, HU: 2023-08-15

Condition(s): Moderately to Severely Active Crohn's Disease
Product: STELARA 130 mg concentrate for solution for infusion, PL2, PL1, STELARA 90 mg solution for injection in pre-filled syringe, STELARA 45 mg solution for injection

Primary endpoint: Clinical remission at Induction Week 8 (Week I-8)

Source: https://euclinicaltrials.eu/ctis-public/view/2023-504978-38-00